EU clinical trial 2024-515871-37-00: OPUS-2 - Oral S1P1 Receptor ModUlation in SLE: A Phase 3, multicenter, randomized, double-blind, placebo-controlled, parallel-group study to evaluate the efficacy, safety, and tolerability of cenerimod in adult subjects with moderate-to-severe systemic lupus erythematosus (SLE) on top of background therapy
Protocol code: ID-064A302
Sponsor: Viatris Innovation GmbH (Pharmaceutical company). Phase: Therapeutic confirmatory (Phase III). Countries: Spain (ongoing, recruitment ended), Germany (ongoing, recruitment ended), Portugal (ongoing, recruitment ended), Poland (ongoing, recruitment ended), Czechia (ongoing, recruitment ended).
Therapeutic area(s): Diseases [C] - Immune System Diseases [C20]
Gender: Female, Male. Age: 18-64 years, 65+ years. Enrolment: 92.
Status: Ongoing, recruitment ended. Start date (EU): 2024-10-24. Decision date: 2024-10-24. Results received: No. Last updated: 2025-12-14.
Decision dates by country: CZ: 2024-10-24, DE: 2024-10-24, PT: 2024-10-28, ES: 2024-11-12, PL: 2024-11-24

Condition(s): Moderate to severe systemic lupus erythematosus
Product: Cenerimod 4 mg, Cenerimod matching placebo

Primary endpoint: Response on Systemic Lupus Erythematosus Responder Index (SRI-4) at Month 12 compared to baseline.
Endpoint(s): Response on British Isles Lupus Assessment Group-based Composite Lupus Assessment (BICLA) at Month 12 compared to baseline., Time to first confirmation of a 4-month sustained mSLEDAI-2K response, defined as a reduction of at least 4 points from baseline., Time to first confirmation of a 4-month sustained response in mucocutaneous manifestations (i.e., rash, alopecia, mucosal ulcers), defined as: • No increase in the overall mSLEDAI-2K score excluding mucocutaneous manifestations, and • Remission (score of zero) from baseline in the mSLEDAI-2K score of mucocutaneous manifestations.

Source: https://euclinicaltrials.eu/ctis-public/view/2024-515871-37-00